EU clinical trial 2025-524727-41-00: J5D-MC-FPAC: A Phase 2a, Randomized, Multicenter, Double-Blind, Placebo-Controlled Proof of Concept Study to Investigate Efficacy and Safety of LY4005130 in Adult Participants With Severe Alopecia Areata
Protocol code: J5D-MC-FPAC
Sponsor: Eli Lilly & Co. (Pharmaceutical company). Phase: Therapeutic exploratory (Phase II). Countries: Poland (ongoing, recruiting), Netherlands (authorised, recruitment pending).
Therapeutic area(s): Diseases [C] - Immune System Diseases [C20]
Gender: Female, Male. Age: 18-64 years. Enrolment: 14.
Start date (EU): 2026-07-07. Decision date: 2026-06-08. Results received: No. Last updated: 2026-07-07.
Decision dates by country: NL: 2026-06-08, PL: 2026-06-12

Condition(s): Alopecia Areata
Product: SUB12581MIG

Primary endpoint: Percentage of Participants Achieving an Absolute Severity of Alopecia Tool (SALT) Less than or Equal to (≤) 20

Source: https://euclinicaltrials.eu/ctis-public/view/2025-524727-41-00